EU clinical trial 2024-520130-29-00: A Phase 2, Double-Blind Study to Evaluate the Pharmacokinetics, Pharmacodynamics, Efficacy, and Safety of Apitegromab in Subjects <2 Years Old With Spinal Muscular Atrophy (SMA) (OPAL)
Protocol code: SRK-015-005
Sponsor: Scholar Rock Inc. (Pharmaceutical company). Phase: Therapeutic exploratory (Phase II). Countries: Belgium (ongoing, recruiting), France (ongoing, recruiting), Italy (ongoing, recruiting), Spain (ongoing, recruiting), Netherlands (ongoing, recruiting).
Therapeutic area(s): Diseases [C] - Congenital, Hereditary, and Neonatal Diseases and Abnormalities [C16]; Phenomena and Processes [G] - Musculoskeletal and Neural Physiological Phenomena [G11]
Gender: Female, Male. Age: 0-17 years. Enrolment: 30.
Status: Ongoing, recruiting. Start date (EU): 2025-12-17. Decision date: 2025-10-21. Results received: No. Last updated: 2026-02-18.
Decision dates by country: BE: 2025-10-21, FR: 2025-10-24, IT: 2025-10-23, ES: 2025-10-23, NL: 2025-10-21

Condition(s): Spinal Muscular Atrophy
Product: APITEGROMAB

Primary endpoint: Population PK model-based parameters such as CL, Vd, Vc and Vp, Apitegromab and total latent myostatin concentrations in serum, Change from baseline in the raw score of the BSID-4 GMS at 48 weeks
Endpoint(s): Relationship of apitegromab concentrations and total latent myostatin concentration in serum, Population PK/PD model-based parameters such as Imax, IC50, and Kout, Incidence of TEAEs and SAEs by severity

Source: https://euclinicaltrials.eu/ctis-public/view/2024-520130-29-00